EU clinical trial 2025-521435-36-01: A randomized placebo controlled trial testing the effect of Zoledronic Acid on Hip osteoarthritis
Protocol code: Project ID: 2018030
Sponsor: Martina Hansens Hospital AS (Hospital/Clinic/Other health care facility). Phase: Therapeutic use (Phase IV). Countries: Norway (authorised, recruitment pending).
Therapeutic area(s): Diseases [C] - Musculoskeletal Diseases [C05]
Gender: Female, Male. Age: 18-64 years, 65+ years. Enrolment: 70.
Status: Authorised, recruitment pending. Decision date: 2025-05-15. Results received: No. Last updated: 2025-05-15.

Condition(s): Osteoarthritis of the Hip

Source: https://euclinicaltrials.eu/ctis-public/view/2025-521435-36-01